EU clinical trial 2023-504169-22-02: Single blind randomized controlled trial to assess the safety and efficacy of high dose pulse intravenous corticosteroid therapy to treat patients with complicated/fulminant acute myocarditis
Protocol code: MYTHS
Sponsor: ASST Grande Ospedale Metropolitano Niguarda (Hospital/Clinic/Other health care facility). Phase: Therapeutic confirmatory (Phase III). Countries: Italy (ongoing, recruiting), Belgium (ongoing, recruiting), Spain (ongoing, recruiting), Austria (ongoing, recruiting), Czechia (ongoing, recruiting), Finland (authorised, recruitment pending), Sweden (not authorised), Slovenia (ongoing, recruiting).
Therapeutic area(s): Diseases [C] - Cardiovascular Diseases [C14]
Gender: Female, Male. Age: 18-64 years, 65+ years. Enrolment: 120.
Start date (EU): 2024-07-31. Decision date: 2024-07-16. Results received: No. Last updated: 2026-03-06.
Decision dates by country: AT: 2025-02-28, SI: 2025-02-07, IT: 2024-07-22, ES: 2024-07-20, BE: 2024-07-16, CZ: 2025-02-26, FI: 2025-02-24

Condition(s): Severe cardiac inflammation
Product: SOLU MEDROL 1000 mg/15,6 ml polvere e solvente per soluzione iniettabile, Sodio cloruro Fresenius Kabi Italia 0,9%, soluzione per infusione

Primary endpoint: The Primary composite endpoint is defined as the time from randomization to the first event occurring within 6 months among: (1) all-cause death, or (2) HTx, or (3) long-term LVAD implant, or (4) need for an upgrading of the t-MCS, or (5) a ventricular tachycardia (VT)/fibrillation (VF) treated with direct current (DC) shock (excluding VT/VF in patients on t-MCS other than IABP), or (6) first rehospitalization due to HF or ventricular arrhythmias, or advanced AV block.
Endpoint(s): The time from randomization to the first event occurring within 6 months among: (1) all-cause death or (2) HTx or (3) long-term LVAD implant or (4) first rehospitalization due to HF or ventricular arrhythmias, or advanced AV block., Mortality: time from randomization to all-cause death within 6 months., In-hospital composite endpoint is defined as the proportion of patients who experience at least one of the following events during index hospitalization: (1) all-cause death, or (2) HTx, or (3) long-term LVAD implant, or (4) need for an upgrading of the t-MCS, or (5) a VT/VF treated with DC shock (excluding VT/VF in patients on t-MCS other than IABP)., Number of days on t-MCS from randomization., Number of days in ICU from randomization., Increase in LVEF on echocardiogram after 5 days from randomization (ECHO clips will be centrally reviewed in a blind fashion by readers)., Relative reduction of troponin levels after 5 days from randomization (ratio of troponin level/local troponin URL)., Reduction in heart rate (HR) on ECG after 3 days from randomization (ECG recorded at the hour of initial randomization - ECGs will be centrally reviewed in a blind fashion by readers)., Proportion of patients with LVEF<55% AND/OR LV dilation on 6-month cardiac magnetic resonance imaging (CMRI) (CMRI clips will be centrally reviewed in a blind fashion by readers)., Proportion of patients with LVEF<55% on 6-month CMRI (CMRI clips will be centrally reviewed in a blind fashion by readers)., Proportion of patients with LV dilation on 6-month CMRI (CMRI clips will be centrally reviewed in a blind fashion by readers).

Source: https://euclinicaltrials.eu/ctis-public/view/2023-504169-22-02